EU clinical trial 2025-524857-15-00: A Multicenter, Open-Label, Phase 1a/b First-in-Human Study to Investigate the Safety, Tolerability, Pharmacokinetics, and Preliminary Antitumor Activity of BG-C0979 in Patients with Selected Advanced Solid Tumors
Protocol code: BG-C0979-101
Sponsor: BeOne Medicines I GmbH (Pharmaceutical company). Phase: Human Pharmacology (Phase I)- First administration to humans. Countries: Spain (ongoing, recruiting).
Therapeutic area(s): Diseases [C] - Neoplasms [C04]
Gender: Female, Male. Age: 18-64 years, 65+ years. Enrolment: 24.
Status: Ongoing, recruiting. Start date (EU): 2026-05-19. Decision date: 2026-04-30. Results received: No. Last updated: 2026-07-28.

Condition(s): Advanced Solid Tumors

Source: https://euclinicaltrials.eu/ctis-public/view/2025-524857-15-00